EU clinical trial 2024-514010-12-00: A First-in-Human Study to Evaluate the Safety and Anti-cancer Activity of the product FS222, which is an Antibody medication, in Subjects with Advanced Malignancies
Protocol code: FS222-19101
Sponsor: Invox Pharma Limited (Pharmaceutical company). Phase: Human Pharmacology (Phase I)- First administration to humans. Countries: Spain (ongoing, recruitment ended), Romania (ongoing, recruitment ended), Netherlands (ongoing, recruitment ended), Germany (ongoing, recruitment ended), Poland (ongoing, recruitment ended).
Therapeutic area(s): Diseases [C] - Neoplasms [C04]
Gender: Female, Male. Age: 18-64 years, 65+ years. Enrolment: 323.
Status: Ongoing, recruitment ended. Start date (EU): 2020-12-03. Decision date: 2024-06-17. Results received: No. Last updated: 2026-03-02.
Decision dates by country: ES: 2024-06-17, PL: 2025-04-06, RO: 2024-07-02, NL: 2025-04-02, DE: 2025-03-28

Condition(s): Advanced Malignancies

Source: https://euclinicaltrials.eu/ctis-public/view/2024-514010-12-00